EU clinical trial 2024-517052-35-00: Early mental response to hormonal treatment in transgender men - The EMRE Study
Sponsor: Karolinska University Hospital (Hospital/Clinic/Other health care facility). Phase: Therapeutic use (Phase IV). Countries: Sweden (authorised, recruitment pending).
Therapeutic area(s): Diseases [C] - Hormonal diseases [C19]; Psychiatry and Psychology [F] - Mental Disorders [F03]
Gender: Male. Age: 18-64 years, 65+ years. Enrolment: 70.
Status: Authorised, recruitment pending. Decision date: 2024-10-01. Results received: No. Last updated: 2024-10-01.

Condition(s): Transsexual, Gender dysphoria

Source: https://euclinicaltrials.eu/ctis-public/view/2024-517052-35-00